EU clinical trial 2023-510220-72-00: PHARMACOLOGICAL STRATEGIES OF INHALED ANTIBIOTHERAPY IN BRONCHIECTASIS WITH CHRONIC BRONCHIAL INFECTION: BRONCHIPHARMA STUDY.
Protocol code: BRONCHIPHARMA I
Sponsor: Consorci Mar Parc De Salut De Barcelona (Hospital/Clinic/Other health care facility). Phase: Therapeutic use (Phase IV). Countries: Spain (authorised, recruitment pending).
Therapeutic area(s): Diseases [C] - Respiratory Tract Diseases [C08]
Gender: Female, Male. Age: 18-64 years, 65+ years. Enrolment: 75.
Status: Authorised, recruitment pending. Decision date: 2024-06-03. Results received: No. Last updated: 2024-06-03.

Condition(s): Adult bronchiectasis
Product: TOBRAMYCIN, Suero Fisiológico Braun 0,9% disolvente para uso parenteral Cloruro de sodio., COLISTIMETHATE SODIUM

Primary endpoint: Number of colony forming units (CFU)

Source: https://euclinicaltrials.eu/ctis-public/view/2023-510220-72-00